EU clinical trial 2023-506287-14-00: AN ADAPTIVE PHASE I/II STUDY TO ASSESS SAFETY, EFFICACY, PHARMACOKINETICS AND PHARMACODYNAMICS OF RO7112689 IN HEALTHY VOLUNTEERS AND PATIENTS WITH PAROXYSMAL NOCTURNAL HEMOGLOBINURIA (PNH)
Protocol code: BP39144
Sponsor: F. Hoffmann-La Roche AG (Pharmaceutical company). Phase: Phase I and Phase II (Integrated)- First administration to humans. Countries: Italy (ended), Germany (ongoing, recruitment ended), Hungary (ended), France (ongoing, recruitment ended).
Therapeutic area(s): Diseases [C] - Hemic and Lymphatic Diseases [C15]
Gender: Female, Male. Age: 18-64 years, 65+ years. Enrolment: 19.
Start date (EU): 2017-04-21. Decision date: 2023-12-22. Results received: No. Last updated: 2025-08-07.
Decision dates by country: HU: 2024-01-08, FR: 2024-01-15, DE: 2023-12-22, IT: 2023-12-29

Condition(s): Paroxysmal nocturnal hemoglobinuria (PNH)
Product: Crovalimab, Crovalimab, Crovalimab Placebo F01-01, Crovalimab

Primary endpoint: 1. Safety (Parts 1, 2, 3, and 4): Incidence of dose-limiting events, 2. Safety (Parts 1, 2, 3, and 4): Incidence and severity of adverse events (AEs), serious adverse events and AEs leading to withdrawal, 3. PD (Parts 1, 2, 3, and 4): Ex vivo liposome lysis in serum and ex-vivo lysis of antibody-coated erythrocytes, 4. PD (Parts 1, 2, 3, and 4): Total and target engaged C5 concentration, 5. PD (Parts 1, 2, 3, and 4): Serum Lactate Dehydrogenase (LDH)
Endpoint(s): 1. Efficacy (Parts 2, 3, and 4): Change in LDH, 2. Efficacy (Parts 2, 3, and 4): Change in free-haemoglobin, 3. Efficacy (Parts 2, 3, and 4): Proportion of patients with stabilized haemoglobin levels, 4. Efficacy (Parts 2, 3, and 4): Change in fatigue as measured by the functional assessment of chronic illness therapy fatigue, 5. Efficacy (Parts 2, 3, and 4): Change in health-related quality of life as measured by the European Organization for Research and Treatment of Cancer quality of life questionnaire-core 30, 6. Efficacy (Parts 2, 3, and 4): Number of packed RBC units transfused per patient, 7. Efficacy (Parts 2, 3, and 4): Time to (1) first transfusion or (2) persistent elevation of LDH, 8. Efficacy (Parts 2, 3, and 4): Proportion of patients with LDH below upper limit of normal (ULN), 9. Efficacy (Parts 2, 3, and 4): Proportion of patients with complement suppression throughout the dosing interval, 10. PK (Parts 1, 2, 3, and 4): Pharmacokinetic profile of crovalimab Cmax, Tmax, Area under the curve (AUC), T1/2, bioavailability following SC administration

Source: https://euclinicaltrials.eu/ctis-public/view/2023-506287-14-00